EU clinical trial 2022-501489-24-00: An Adaptive Phase 3, Randomized, Open-Label, Multicenter Study to Compare the Efficacy and Safety of Axicabtagene Ciloleucel versus Standard of Care Therapy as First-Line Therapy in Subjects with High-Risk Large B-Cell Lymphoma (ZUMA-23)
Protocol code: KT-US-484-0136
Sponsor: Kite Pharma Inc. (Pharmaceutical company). Phase: Therapeutic confirmatory (Phase III). Countries: Austria (ongoing, recruitment ended), Italy (ongoing, recruitment ended), Germany (ongoing, recruitment ended), France (ongoing, recruitment ended), Netherlands (ongoing, recruitment ended), Portugal (ongoing, recruitment ended), Spain (ongoing, recruitment ended).
Therapeutic area(s): Diseases [C] - Hemic and Lymphatic Diseases [C15]
Gender: Female, Male. Age: 18-64 years, 65+ years. Enrolment: 117.
Status: Ongoing, recruitment ended. Start date (EU): 2025-03-28. Decision date: 2023-08-28. Results received: No. Last updated: 2026-06-19.
Decision dates by country: FR: 2023-08-28, AT: 2023-09-04, IT: 2023-09-04, NL: 2023-08-29, DE: 2023-09-01, ES: 2023-09-01, PT: 2023-08-30

Condition(s): First-line treatment of adult subjects with high-risk large B-cell lymphoma (LBCL) including diffuse large B-cell lymphoma, not otherwise specified (DLBCL, NOS) and high-grade B-cell lymphoma (HGBL).
Product: YESCARTA 0.4 – 2 x 10e8 cells dispersion for infusion

Primary endpoint: Event-free survival (EFS) by blinded central assessment.
Endpoint(s): Progression-free survival (PFS) by blinded central assessment., Overal survival (OS), PFS by investigator assessment., Complete remission (CR) rate by blinded central assessment., Incidence of adverse events (AEs), serious adverse events (SAEs), deaths, and clinically significant changes in safety laboratory values, Patient-reported outcome (PRO)-QOL as measured by European Organisation for Research and Treatment of Cancer Quality of Life Questionnaire (EORTC-QLQ-C30), European Organisation for Research and Treatment of Cancer Quality of Life Questionnaire – Non-Hodgkin Lymphoma High Grade Module (EORTC QLQ-NHL-HG29), and European Quality of Life 5-Dimension 5-Level Scale (EQ-5D-5L).

Source: https://euclinicaltrials.eu/ctis-public/view/2022-501489-24-00